EU clinical trial 2025-523618-10-00: A Multicenter, Open-label, Long-term, Safety, Tolerability, and Efficacy Study of Azetukalner in Major Depressive Disorder
Protocol code: XPF-010-D303
Sponsor: Xenon Pharmaceuticals Inc. (Pharmaceutical company). Phase: Therapeutic confirmatory (Phase III). Countries: Finland (ongoing, recruiting), Poland (ongoing, recruiting), Romania (authorised, recruiting), Slovakia (authorised, recruiting), Spain (authorised, recruitment pending), Germany (authorised, recruiting).
Therapeutic area(s): Psychiatry and Psychology [F] - Mental Disorders [F03]
Gender: Female, Male. Age: 18-64 years, 65+ years. Enrolment: 145.
Start date (EU): 2026-06-04. Decision date: 2026-03-30. Results received: No. Last updated: 2026-07-27.
Decision dates by country: PL: 2026-04-03, FI: 2026-04-30, DE: 2026-06-26, ES: 2026-05-04, SK: 2026-03-30, RO: 2026-04-06

Condition(s): Major Depressive Disorder
Product: XPF-010

Primary endpoint: Severity and frequency of TEAEs, SAEs, AESIs, and ECIs,
Endpoint(s): Change from baseline in the HAMD-17 total score over time., Change from baseline in the SHAPS total score over time., Change in the CGI-S score over time., Change from baseline in Q-LES-Q-SF total score, Q-LES-Q-SF medication and life satisfaction and contentment in item scores, and SDS total score and subscale scores over time.

Source: https://euclinicaltrials.eu/ctis-public/view/2025-523618-10-00